EU clinical trial 2024-516988-87-00: CDX0159-07: A Phase 2 Randomized, Double-Blind, Placebo-Controlled, Dose ranging Study to Assess the Efficacy and Safety of CDX 0159 in Patients with Chronic Inducible Urticaria
Protocol code: CDX0159-07
Sponsor: Celldex Therapeutics Inc. (Pharmaceutical company). Phase: Therapeutic exploratory (Phase II). Countries: Poland (ended), Bulgaria (ended), Latvia (ended), Spain (ended), Hungary (ended), Germany (ended), Lithuania (ended).
Therapeutic area(s): Diseases [C] - Skin and Connective Tissue Diseases [C17]
Gender: Female, Male. Age: 18-64 years, 65+ years. Enrolment: 114.
Status: Ended. Start date (EU): 2022-11-09. End date (EU): 2025-09-12. End date: 2025-09-13. Decision date: 2024-11-13. Results received: No. Last updated: 2025-09-12.
Decision dates by country: HU: 2024-11-15, LV: 2024-11-13, LT: 2024-11-28, ES: 2024-11-13, DE: 2024-11-18, BG: 2024-11-27, PL: 2024-11-16

Condition(s): Chronic Inducible Urticaria
Product: BARZOLVOLIMAB

Primary endpoint: Proportion (%) of patients with a negative provocation test at Week 12 in the ColdU subtype cohort (X) For ColdU patients, a negative provocation test is defined as absence of wheals at the provocation site within 10 min at ≤ 4°C after provocation using TempTest®, Proportion (%) of patients with a negative provocation test at Week 12 in the SD subtype cohort (X) For SD patients, a negative provocation test is defined as absence of wheals at the provocation site within 10 min at 0 pins after provocation using the FricTest®
Endpoint(s): Mean change from baseline to Week 12 in CTT in the ColdU subtype cohort, Mean change from baseline to Week 12 in CFT in the SD subtype cohort, Mean change from baseline to Week 12 in WI-NRSprovo in the ColdU subtype cohort, Mean change from baseline to Week 12 in WI-NRSprovo in the SD subtype cohort, Proportion (%) of patients with a negative provocation test at Week 12 in the combined CIndU subtype cohorts, Mean change from baseline to Week 12 in WI-NRSprovo in the combined CIndU subtype cohorts, Proportion (%) of patients experiencing TEAEs over the 20-week treatment period by subtype cohort and in the combined CIndU subtype cohorts

Source: https://euclinicaltrials.eu/ctis-public/view/2024-516988-87-00